EU clinical trial 2023-509360-24-00: A Randomized, Multicenter, Double Blind, Phase III Study of Adjuvant Nivolumab or Placebo in Subjects with Resected Esophageal, or Gastroesophageal Junction Cancer
Protocol code: CA209-577
Sponsor: Bristol Myers Squibb International Corporation (Pharmaceutical company). Phase: Therapeutic confirmatory (Phase III). Countries: Belgium (ended), Spain (ended), Romania (ended), Ireland (ended), Czechia (ended), France (ended), Poland (ended), Denmark (ended), Netherlands (ended), Germany (ended).
Therapeutic area(s): Diseases [C] - Neoplasms [C04]
Gender: Female, Male. Age: 18-64 years, 65+ years. Enrolment: 275.
Status: Ended. Start date (EU): 2016-06-16. End date (EU): 2024-11-06. End date: 2024-11-08. Decision date: 2024-03-13. Results received: Yes. Last updated: 2024-12-02.
Decision dates by country: BE: 2024-04-19, CZ: 2024-03-14, DK: 2024-03-13, DE: 2024-03-15, IE: 2024-03-13, RO: 2024-03-18, NL: 2024-03-13, FR: 2024-04-29, ES: 2024-03-13, PL: 2024-03-15

Condition(s): Subjects with resected adenocarcinoma or squamous cell carcinoma esophageal or gastroesophageal junction cancer
Product: Placebo for BMS-936558, OPDIVO 10 mg/mL concentrate for solution for infusion.

Primary endpoint: Disease-free survival is the primary endpoint of this study. Disease-free survival is the time between randomization date and first date of recurrence or death, whichever occurs first.
Endpoint(s): Overall survival and overall survival rates are secondary endpoints. -Overall Survival is time between the date of randomization and the date of death. For subjects without documentation of death, OS will be censored on the last date the subject was known to be alive. -The overall survival rate at 1, 2, and 3 years is defined as the probability that a subject is alive at 1, 2, and 3 years, respectively, following randomization.

Source: https://euclinicaltrials.eu/ctis-public/view/2023-509360-24-00